EU clinical trial 2023-505698-34-00: A Phase 2, Multicenter, Clinical Study to Evaluate the Safety and Efficacy of MK-1308A (Coformulated MK-1308/MK-3475) in Combination with Lenvatinib (E7080/MK-7902) in First-line Therapy of Participants with Advanced Hepatocellular Carcinoma
Protocol code: MK1308A-004
Sponsor: Merck Sharp & Dohme LLC (Pharmaceutical company). Phase: Therapeutic exploratory (Phase II). Countries: Spain (ended), Italy (ended), Poland (ended).
Therapeutic area(s): Diseases [C] - Neoplasms [C04]
Gender: Female, Male. Age: 18-64 years, 65+ years. Enrolment: 26.
Status: Ended. Start date (EU): 2021-07-13. End date (EU): 2025-07-22. End date: 2025-07-29. Decision date: 2023-07-27. Results received: Yes. Last updated: 2025-03-05.
Decision dates by country: PL: 2023-09-18, ES: 2023-07-27, IT: 2023-09-08

Condition(s): Hepatocellular carcinoma
Product: Lenvatinib, MK-1308A, KEYTRUDA 25 mg/mL concentrate for solution for infusion

Primary endpoint: Number of participants with a Dose-Limiting Toxicity (DLT) in the Safety Lead-in Phase, Number of participants with ≥1 adverse event (AE), Number of participants with ≥1 serious adverse event (SAE), Number of participants with ≥1 immune-related AE (irAE), Number of participants with ≥1 hepatic AEs, Number of participants discontinuing study treatment due to an AE, Objective Response Rate (ORR) per Response Evaluation Criteria in Solid Tumors version 1.1 (RECIST 1.1) as assessed by blinded independent central review (BICR)
Endpoint(s): Duration of Response (DOR) per RECIST 1.1 as assessed by BICR, Disease Control Rate (DCR) per RECIST 1.1 as assessed by BICR, Progression Free Survival (PFS) per RECIST 1.1 as assessed by BICR, Time-To-Progression (TTP) per RECIST 1.1 as assessed by BICR, Overall Survival (OS), ORR per modified RECIST (mRECIST) as assessed by BICR, DOR per mRECIST as assessed by BICR, DCR per mRECIST as assessed by BICR, PFS per mRECIST as assessed by BICR, TTP per mRECIST as assessed by BICR

Source: https://euclinicaltrials.eu/ctis-public/view/2023-505698-34-00